EU clinical trial 2024-516785-12-00: SPI-62 as a Treatment for Hypercortisolism Related to a Benign Adrenal Tumor
Protocol code: SPI-62-CL-2002
Sponsor: Sparrow Pharmaceuticals Inc. (Pharmaceutical company). Phase: Therapeutic exploratory (Phase II). Countries: Romania (ended).
Therapeutic area(s): Diseases [C] - Hormonal diseases [C19]
Gender: Female, Male. Age: 18-64 years, 65+ years. Enrolment: 1.
Status: Ended. End date (EU): 2025-02-14. Decision date: 2024-10-07. Results received: Yes. Last updated: 2024-10-07.

Condition(s): Hypercortisolism related to benign adrenal tumour

Primary endpoint: "an evaluation of the benefit-risk profile of SPI-62 consisting of laboratory data, incidence of treatment emergent adverse events (TEAEs), progression, or regression, of underlying disease or its complications"
Endpoint(s): "short-term progression, persistence, improvement, or resolution of clinical signs, markers, and symptom of hypercortisolism including: hyperglycemia, dyslipidemia, osteopenia, hypertension, and other features associated with endogenous hypercortisolism. Long-term safety relating to serious morbidity or mortality"

Source: https://euclinicaltrials.eu/ctis-public/view/2024-516785-12-00